EU clinical trial 2024-515625-29-00: Doxapram versus placebo in preterm newborns: An international double blinded multicenter randomized controlled trial
Protocol code: NL72125.078.19
Sponsor: Erasmus Universitair Medisch Centrum Rotterdam (Erasmus MC) (Hospital/Clinic/Other health care facility). Phase: Therapeutic confirmatory (Phase III). Countries: Netherlands (ongoing, recruiting), Belgium (ongoing, recruiting).
Therapeutic area(s): Not possible to specify
Gender: Female, Male. Age: 0-17 years. Enrolment: 300.
Status: Ongoing, recruiting. Start date (EU): 2020-06-16. Decision date: 2024-11-11. Results received: No. Last updated: 2024-11-13.
Decision dates by country: BE: 2024-11-13, NL: 2024-11-11

Condition(s): Apnea of prematurity
Product: Glucose 5% 50 ml

Primary endpoint: Primary outcome will be the composite outcome of death or severe disability at the age of 18-24 months corrected age. Both outcomes will also be analyzed seperately.

Source: https://euclinicaltrials.eu/ctis-public/view/2024-515625-29-00